EU clinical trial 2023-507881-19-00: Vaccination to prevent Mpox Infection (MPOX-VAX Study)
Sponsor: University College Dublin (Educational Institution). Phase: Therapeutic use (Phase IV). Countries: Ireland (ongoing, recruitment ended).
Therapeutic area(s): Diseases [C] - Virus Diseases [C02]
Gender: Female, Male. Age: 18-64 years. Enrolment: 218.
Status: Ongoing, recruitment ended. Start date (EU): 2024-06-29. Decision date: 2024-03-08. Results received: No. Last updated: 2026-02-04.
Decision dates by country: IE: 2024-04-17

Condition(s): Mpox infection
Product: IMVANEX suspension for injection Smallpox and monkeypox vaccine (Live Modified Vaccinia Virus Ankara), IMVANEX suspension for injection Smallpox and monkeypox vaccine (Live Modified Vaccinia Virus Ankara)

Primary endpoint: Mean geometric MVA-specific antibody titres at week 48, Mean rate of change in MVA-specific antibody titres post week 6 to week 48
Endpoint(s): Absolute mean change from baseline in MVA-specific antibody 6 weeks post first vaccine, Neutralising capacity of vaccine-induced immune response for Mpox virus in vitro culture at weeks 6 and 48, Detection of Mpox-specific antibodies at week 0,2,6,12 and 48, Detection of Mpox DNA on anorectal, throat or vaginal swabs at week 0, 2, 6, 12 and 48., Frequency of active STIs at inclusion (HAV (IgM), HBV, HCV, Syphilis, Chlamydia and Gonorrhoea and frequency of participants with chronic HIV infection, HBV or HCV, Incidence of STIs (HAV (IgM), HBV, HCV, HIV, Syphilis, Chlamydia and Gonorrhoea) at week 6,12 and 48

Source: https://euclinicaltrials.eu/ctis-public/view/2023-507881-19-00